EU clinical trial 2024-519162-46-00: A First-in-Human Study to Test the Safety and Effects of the Investigational Drug IPH4502 in People with Advanced Cancers
Protocol code: IPH4502-101
Sponsor: Innate Pharma (Pharmaceutical company). Phase: Human Pharmacology (Phase I)- First administration to humans. Countries: France (ongoing, recruiting).
Therapeutic area(s): Diseases [C] - Neoplasms [C04]
Gender: Female, Male. Age: 18-64 years, 65+ years. Enrolment: 25.
Status: Ongoing, recruiting. Start date (EU): 2025-04-25. Decision date: 2025-03-13. Results received: No. Last updated: 2026-06-08.

Condition(s): Advanced Solid Tumors

Source: https://euclinicaltrials.eu/ctis-public/view/2024-519162-46-00